EU clinical trial 2025-525158-20-00: Pharmacokinetics, safety, and immunogenicity comparison of Bmab1700 and Opdivo® as adjuvant monotherapy in patients with melanoma
Protocol code: BIO-NIVOLU-103
Sponsor: Biocon Biologics UK PLC (Pharmaceutical company). Phase: Human Pharmacology (Phase I)- First administration to humans. Countries: Spain (authorised, recruitment pending), Romania (authorised, recruitment pending).
Therapeutic area(s): Diseases [C] - Neoplasms [C04]
Gender: Female, Male. Age: 18-64 years, 65+ years. Enrolment: 43.
Status: Authorised, recruitment pending. Decision date: 2026-06-22. Results received: No. Last updated: 2026-07-01.
Decision dates by country: RO: 2026-07-01, ES: 2026-06-22

Condition(s): Stage IIB/C, Stage III, or Stage IV Melanoma

Source: https://euclinicaltrials.eu/ctis-public/view/2025-525158-20-00